EU clinical trial 2024-516338-37-00: A phase Ib study to investigate the safety and effect of BR-003
Protocol code: STX-102
Sponsor: SentryX B.V. (Pharmaceutical company). Phase: Human Pharmacology (Phase I)- First administration to humans. Countries: Netherlands (ended).
Therapeutic area(s): Analytical,Diagnostic,Therapeutic Techniques and Equipment [E]-Surgical Procedures, Operative [E04]
Gender: Female, Male. Age: 18-64 years, 65+ years. Enrolment: 6.
Status: Ended. Start date (EU): 2023-05-11. End date (EU): 2025-02-18. End date: 2025-02-19. Decision date: 2024-08-09. Results received: No. Last updated: 2024-08-09.

Condition(s): Patients planned for open or percutaneous posterior spinal stabilisation with 4 or 6 pedicle screws with a diameter of 5 to 7.5 mm (inclusive), with or without concomitant posterolateral fusion, vertebral augmentation, intervertebral body fusion devices, osteotomies, and posterior decompression.

Source: https://euclinicaltrials.eu/ctis-public/view/2024-516338-37-00